EU clinical trial 2025-520482-52-03: Clinical Application of the Androgen Receptor Inhibitor Darolutamide to Upregulate the Prostate-Specific Membrane Antigen (PSMA) Protein Expression in Patients with Hormone Sensitive Prostate Cancer. - The DARO-flare Trial -
Sponsor: Amsterdam UMC Stichting (Patient organisation/association). Phase: Phase I and Phase II (Integrated)- Other. Countries: Netherlands (authorised, recruitment pending).
Therapeutic area(s): Analytical, Diagnostic and Therapeutic Techniques and Equipment [E] - Diagnosis [E01]; Diseases [C] - Male Urogenital Diseases [C12]
Gender: Male. Age: 18-64 years, 65+ years. Enrolment: 32.
Status: Authorised, recruitment pending. Decision date: 2025-12-04. Results received: No. Last updated: 2026-03-18.

Condition(s): Prostate cancer
Product: NUBEQA 300 mg film-coated tablets

Primary endpoint: Number of lesions, Size of lesions, measured in mm, Location of lesions, distinguished in lymph node, bone, visceral, other, SUVmax, Cohort 1 - The appearance of at least 1 new PSMA-positive lesion compared to baseline PSMA PET/CT, with a SUVmax > liver (according to SPARC guidelines), Cohort 1 - A clinical significant increase in SUVmax of existing lesions (≥20%), Cohort 1 - An increase in the total number of metastatic lesions above 5 compared to baseline PSMA PET/CT (shifting from an oligo-metastatic to poly-metastatic disease stage), Cohort 2 - The appearance of at least 1 metastatic lesion (lymph node or bone) suspicious for prostate cancer with a SUVmax > liver (according to SPARC guidelines), Cohort 2 - The detection of local recurrence of disease in the absence of metastatic disease with a SUVmax > liver (according to SPARC guidelines), Cohort 2 - The detection of local recurrence of disease with local or a metastatic lesion suspicious for prostate cancer with either of the two having a SUVmax > liver (according to SPARC guidelines)
Endpoint(s): Number of lesions, Size of lesions, measured in mm, Location of lesions, distinguished in lymph node, bone, visceral, other, SUVmax, Questionnaire on health-related quality of life, Number of AE and SAE, recorded by NCI Common Terminology Criteria for Adverse Events (CTCAE v5.0)

Source: https://euclinicaltrials.eu/ctis-public/view/2025-520482-52-03